EU clinical trial 2024-516810-39-00: Adjuvant immunotherapy after salvage surgery in head and neck squamous cell carcinoma: phase 2 trial evaluating the efficacy and the toxicity of nivolumab alone, and of the combination nivolumab and ipilimumab - ADJORL1
Protocol code: CSET N°2017/2536
Sponsor: Institut Gustave Roussy (Hospital/Clinic/Other health care facility). Phase: Therapeutic exploratory (Phase II). Countries: France (ongoing, recruiting).
Therapeutic area(s): Diseases [C] - Neoplasms [C04]
Gender: Female, Male. Age: 18-64 years, 65+ years. Enrolment: 140.
Status: Ongoing, recruiting. Start date (EU): 2018-02-13. Decision date: 2024-10-29. Results received: No. Last updated: 2025-04-22.
Decision dates by country: FR: 2024-10-31

Condition(s): Adjuvant therapy after salvage surgery of high risk recurrent head and neck squamous cell carcinoma (HNSCC)
Product: Ipilimumab, OPDIVO 10 mg/mL concentrate for solution for infusion., Ipilimumab

Primary endpoint: Two-years DFS, defined as the time from the beginning of the immunotherapy and the first locoregional or distant recurrence, or death from any cause, in cohorts 1 and 2
Endpoint(s): Two-years DFS in cohorts 1bis and 2 bis, Grade 3, 4, 5 toxicity, quality of life, 1-year and 2-year overall survival, DFS in subgroups determined by HPV analysis, immunoscore, PDL1 immunohistochemistry (all cohorts), PK, PD assessments

Source: https://euclinicaltrials.eu/ctis-public/view/2024-516810-39-00